EU clinical trial 2024-511114-20-00: SEMAFORCRANIO : Multicenter, double-blind, parallel, randomized controlled trial of the efficacy of semaglutide in hypothalamic obesity secondary to craniopharyngioma in children aged 12 to 17 years
Protocol code: 49RC23_0307
Sponsor: Centre Hospitalier Universitaire D'Angers (Hospital/Clinic/Other health care facility). Phase: Therapeutic confirmatory (Phase III). Countries: France (authorised, recruitment pending).
Therapeutic area(s): Diseases [C] - Nervous System Diseases [C10]
Gender: Female, Male. Age: 0-17 years. Enrolment: 50.
Status: Authorised, recruitment pending. Decision date: 2026-04-27. Results received: No. Last updated: 2026-06-26.

Condition(s): Craniopharyngioma
Product: Wegovy 2.4 mg solution for injection in pre-filled pen, Semaglutide Placebo (Wegovy 2.4 mg solution for injection in pre-filled pen

Primary endpoint: Change in BMI (in standard deviations for age and sex according to French reference values) after 40 weeks of semaglutide treatment (dose escalation over 16 weeks followed by a maximum maintenance dose of 2.4 mg/week for 24 weeks) compared to placebo. treatment (dose escalation over 16 weeks followed by a maximum maintenance dose of 2.4 mg/week during 24 weeks) versus placebo, Evolution of BMI-DS between baseline and S80: “semaglutide from S0” arm vs “semaglutide from S40” arm.

Source: https://euclinicaltrials.eu/ctis-public/view/2024-511114-20-00